EU clinical trial 2023-503923-24-00: A Phase 3 Randomized, Double-blind, Placebo-controlled Study to Evaluate the Efficacy and Safety of Dazodalibep in Participants With Sjögren’s Syndrome With Moderate-to Severe Symptom State
Protocol code: HZNP-DAZ-303
Sponsor: Horizon Therapeutics Ireland Designated Activity Company (Pharmaceutical company). Phase: Therapeutic confirmatory (Phase III). Countries: Denmark (ended), Belgium (ongoing, recruitment ended), Slovenia (ongoing, recruitment ended), Spain (ongoing, recruitment ended), Hungary (ongoing, recruitment ended), Greece (ongoing, recruitment ended), Croatia (ended), France (ongoing, recruitment ended), Poland (ongoing, recruitment ended), Portugal (ongoing, recruitment ended), Germany (ongoing, recruitment ended), Italy (ongoing, recruitment ended).
Therapeutic area(s): Phenomena and Processes [G] - Immune System Phenomena [G13]; Diseases [C] - Immune System Diseases [C20]; Phenomena and Processes [G] - Immune system processes [G12]
Gender: Female, Male. Age: 18-64 years, 65+ years. Enrolment: 194.
Start date (EU): 2024-07-22. Decision date: 2024-06-17. Results received: No. Last updated: 2026-03-24.
Decision dates by country: FR: 2024-06-21, BE: 2024-06-17, DE: 2024-06-20, PT: 2024-06-19, DK: 2024-06-17, SI: 2024-06-18, HR: 2024-06-21, ES: 2024-06-17, GR: 2024-06-21, HU: 2024-06-18, PL: 2024-08-20, IT: 2024-06-21

Condition(s): Sjögren’s Syndrome With Moderate-toSevere Symptom State
Product: Dazodalibep, The placebo is formulated as sterile liquid intended for intravenous infusion following dilution in normal saline. The nominal volume in each vial is 5.0 mL. The placebo is aseptically filled into 6R glass vials, stoppered with a Flurotec-coated elastomeric stopper, and sealed with an aluminum overseal.

Primary endpoint: (1-2) "1. Change from baseline in Diary for Assessing Sjögren’s Patient Reported Index (DASPRI) score at Week 48 (Plan A) 2. Change from baseline in EULAR Sjögren’s Syndrome Patient Reported Index (ESSPRI) score at Week 48 (Plan B)
Endpoint(s): "1. Proportion of participants achieving a meaningful improvement in DASPRIb (Plan A) or ESSPRI[1.5] (Plan B) response, defined as a decrease of at least 1.5 points from baseline in the ESSPRI score, without premature discontinuation from treatment and without receiving rescue or potentially confounding therapy., "2. Change from baseline in DASPRI Dryness (Plan A) or ESSPRI Dryness (Plan B) at Week 48", "3. Change from baseline in Patient-Reported Outcomes Measurement Information System Fatigue-Short Form 10a (PROMIS-Fatigue SF-10a) at Week 48 (Plan A and Plan B)", "4. Change from baseline in DASPRI Pain (Plan A) or ESSPRI Pain (Plan B) at Week 48", "5. Change from baseline in at Week 48 (Plan B only)", "6. Change from baseline in DASPRI total score (Plan A) or ESSPRI total score (Plan B) at Week 12 and Week 24", "7. Change from baseline in DASPRI Fatigue (Plan A) or ESSPRI Fatigue (Plan B) at Week 48", "8. Change from baseline in total stimulated salivary flow at Week 48 (Plan A and Plan B).", " 9. Pharmacokinetic concentration of dazodalibep in plasma including maximum plasma concentration (Cmax) and minimum plasma concentration (Cmin).", "10. Incidence of treatment-emergent adverse events (TEAEs), treatment-emergent serious adverse events (TESAEs), and adverse events of special interest (AESIs)."

Source: https://euclinicaltrials.eu/ctis-public/view/2023-503923-24-00